EU clinical trial 2022-500714-25-01: Congenital CMV treated with valaciclovir during pregnancy: a prospective cohort study
Sponsor: UZ Leuven (Hospital/Clinic/Other health care facility). Phase: Therapeutic confirmatory (Phase III). Countries: Belgium (ongoing, recruitment ended).
Therapeutic area(s): Diseases [C] - Virus Diseases [C02]; Diseases [C] - Congenital, Hereditary, and Neonatal Diseases and Abnormalities [C16]
Gender: Female. Age: In utero, 18-64 years. Enrolment: 112.
Status: Ongoing, recruitment ended. Start date (EU): 2024-06-19. Decision date: 2023-08-16. Results received: No. Last updated: 2025-03-13.

Condition(s): congenital CMV infection
Product: Valaciclovir Sandoz 500 mg filmomhulde tabletten

Primary endpoint: The rate of vertical transmission, assessed by CMV PCR on amniotic fluid collected during an amniocentesis at 20w. This result will be reconfirmed by PCR on a urine sample postnatally.
Endpoint(s): Imaging abnormalities indicative for vertical transmission assed on ultrasound two weekly and on MRI at 30w GA., Maternal safety assessed by blood analysis (hematology, liver function, kidney function) and clinically, Fetal safety assessed by ultrasound prenatally, blood analysis at birth on umbilical cord blood (hematology, liver function), postnatal urine sample, MRI postnatally, Long term effects: hearing assessment yearly until year 4 and neurodevelopmental follow-up at 1,2 and 5 years of age.

Source: https://euclinicaltrials.eu/ctis-public/view/2022-500714-25-01